EU clinical trial 2023-506137-30-00: A randomized, multi-centre, double-blind, phase II clinical trial of dose finding of Montelukast in patients with erosive osteoarthritis of the hands. HOME study.
Protocol code: FMLD-ARSIDOS-55_FII
Sponsor: Farmalider S.A. (Pharmaceutical company). Phase: Therapeutic exploratory (Phase II). Countries: Spain (ended).
Therapeutic area(s): Diseases [C] - Musculoskeletal Diseases [C05]
Gender: Female, Male. Age: 18-64 years, 65+ years. Enrolment: 50.
Status: Ended. Start date (EU): 2024-01-11. End date (EU): 2024-09-17. Decision date: 2023-11-06. Results received: Yes. Last updated: 2023-11-06.

Condition(s): Erosive osteoarthritis of the hands
Product: Montelukast B, Montelukast D, Placebo, Montelukast C, Montelukast A

Primary endpoint: Difference in pain intensity (PID) of the most affected hand with respect to baseline pain at 8 weeks of treatment with different doses of Montelukast of 5, 10, 15 and 30 mg, compared to placebo, measured through the Visual Analogue Scale (VAS).
Endpoint(s): EFFICACY ENDPOINTS:The PID with respect to baseline pain of the most affected hand at 4 weeks of treatment with different doses of Montelukast of 5, 10, 15 and 30 mg, compared to placebo, measured through the VAS, Difference in the score of AUSCAN subscales (pain, stiffness and physical function) of the most affected hand with respect to baseline at 4 and 8 weeks of treatment with different doses of Montelukast of 5, 10, 15 and 30 mg, compared to placebo., Difference in the hand grip strength of the most affected hand with respect to baseline at 4 and 8 weeks of treatment with different doses of Montelukast 5, 10, 15 and 30 mg, compared to placebo, measured using a dynamometer (previously inflated to 60 mmHg)., Proportion of patients using rescue medication at 4 and 8 weeks of treatment with different doses of Montelukast 5, 10, 15 and 30 mg, compared to placebo., Amount of rescue medication used in each treatment group, compared to placebo at 4 and 8 weeks of treatment with different doses of Montelukast 5, 10, 15 and 30 mg., Difference in the quality of life with respect to baseline at 4 and 8 weeks of treatment with different doses of Montelukast 5, 10, 15 and 30 mg, compared to placebo, using the EuroQol-5D-5L quality of life questionnaire., Difference in the sleeping difficulty due to pain of the most affected hand with respect to baseline at 4 and 8 weeks of treatment, using a generic question: “During the last week, how many times have you had trouble sleeping because of pain in your hand?”., SAFETY ENDPOINTS: Vital signs (body temperature, heart rate, blood pressure) and physical examination at baseline, 4 and 8 weeks., Analytical parameters at baseline and 8 weeks of treatment., Adverse events throughout the study., EFFICACY ENDPOINT: Difference in the AUSCAN total score of the most affected hand with respect to baseline at 4 and 8 weeks of treatment with different doses of Montelukast of 5, 10, 15 and 30 mg, compared to placebo.

Source: https://euclinicaltrials.eu/ctis-public/view/2023-506137-30-00